EU clinical trial 2024-516312-25-00: Characterisation and intervention study in patients with long-term use of nasal decongestants.
Protocol code: AGO/2019/005
Sponsor: Universitair Ziekenhuis Gent (Hospital/Clinic/Other health care facility). Phase: Therapeutic use (Phase IV). Countries: Belgium (ended).
Therapeutic area(s): Diseases [C] - Otorhinolaryngologic Diseases [C09]
Gender: Female, Male. Age: 18-64 years, 65+ years. Enrolment: 135.
Status: Ended. Start date (EU): 2024-09-05. End date (EU): 2025-04-30. Decision date: 2024-09-05. Results received: Yes. Last updated: 2024-09-05.

Condition(s): rhinitis medicamentosa
Product: MOMETASONE

Primary endpoint: Proportion of study subjects with overuse of nasal decongestants able to completely withdraw the use of the nasal decongestant. For this study, complete withdrawal is defined as at least 7 consecutive days without any use of a nasal decongestant., Co-primary end point: Proportion of study subjects who were able to completely withdraw the overuse of nasal decongestants at the followup 2 (T3, after 12 weeks of intervention) who relapsed by the time of follow-up 3 (T4, 6 months after the start-up of the intervention) For this study, relapse is defined as daily use of a nasal decongestant for more than 7 consecutive days after prior full withdrawal of the nasal decongestant.
Endpoint(s): Change from intervention baseline (T1) in Rhinitis Control Assessment Test (RCAT) score, Change from intervention baseline (T1) in home measured Peak Nasal Inspiratory Flow (PNIF) as captured in the daily diary on a fixed day every week / Change from intervention baseline (T1) in hospital measured PNIF / Change from intervention baseline (T1) in visual analogue scale (VAS) for nasal obstruction / Change from intervention baseline (T1) in nasal symptom score(s) as captured in the daily diary, Change from intervention baseline (T1) in Mini Rhinoconjunctivitis Quality of Life Questionnaire (miniRQLQ), Change from intervention baseline (T1) in PROMIS Sleep Disturbance short form 8b, Change in nasal endoscopy outcomes

Source: https://euclinicaltrials.eu/ctis-public/view/2024-516312-25-00